EU clinical trial 2023-506064-14-00: Physiologically based pharmacokinetic modelling of intravenous and intranasal formulations of naloxone in healthy volunteers
Protocol code: 2023-506064-14-00
Sponsor: Parc De Salut Mar (Hospital/Clinic/Other health care facility). Phase: Human Pharmacology (Phase I)- Other. Countries: Spain (ended).
Therapeutic area(s): Analytical, Diagnostic and Therapeutic Techniques and Equipment [E] - Therapeutics [E02]
Gender: Female, Male. Age: 18-64 years. Enrolment: 8.
Status: Ended. Start date (EU): 2024-03-05. End date (EU): 2024-05-14. Decision date: 2024-02-23. Results received: No. Last updated: 2024-02-23.

Condition(s): Healthy volunteers

Source: https://euclinicaltrials.eu/ctis-public/view/2023-506064-14-00